EU clinical trial 2024-519451-29-00: Phase II, Open-Label Study of preliminary efficacy of Sitravatinib in Combination with Tislelizumab in Patients with Metastatic Uveal Melanoma with liver metastases.
Protocol code: GEM-2101
Sponsor: Grupo Espanol Multidisciplinar De Melanoma (Patient organisation/association). Phase: Therapeutic exploratory (Phase II). Countries: Spain (ended).
Therapeutic area(s): Diseases [C] - Neoplasms [C04]
Gender: Female, Male. Age: 18-64 years, 65+ years. Enrolment: 16.
Status: Ended. Start date (EU): 2022-09-23. End date (EU): 2025-05-06. Decision date: 2024-12-10. Results received: Yes. Last updated: 2024-12-10.

Condition(s): Uveal melanoma
Product: Sitravatinib, Tislelizumab, Sitravatinib

Primary endpoint: Objective Response rate (ORR) according to RECIST 1.1 criteria
Endpoint(s): Secondary efficacy endpoints: 1. Progression Free Survival (PFS) according to RECIST 1.1 criteria. For this protocol, PFS is defined as the time from the first dose of study treatment until objective tumor progression or death according to section 12.1.2., Overall Survival (OS). Overall Survival is defined as the time from the first dose of study treatment until death from any cause.

Source: https://euclinicaltrials.eu/ctis-public/view/2024-519451-29-00